EU clinical trial 2024-518120-68-01: Prevention of Sexual Offending with Cognitive Behavioral Therapy Alone Versus Therapy Combined with Testosterone Suppression – the PREVENT-MED randomized clinical trial
Protocol code: PREVENT-MED
Sponsor: Vaestra Goetalandsregionen (Hospital/Clinic/Other health care facility). Phase: Therapeutic exploratory (Phase II). Countries: Sweden (authorised, recruitment pending).
Therapeutic area(s): Psychiatry and Psychology [F] - Mental Disorders [F03]
Gender: Male. Age: 18-64 years, 65+ years. Enrolment: 180.
Status: Authorised, recruitment pending. Decision date: 2026-04-24. Results received: No. Last updated: 2026-04-24.

Condition(s): Paraphilic disorder, Compulsive sexual behavior disorder
Product: TESTOSTERONE, DEGARELIX, Placebo gel identical to testosterone gel

Primary endpoint: Total score on the Sexual Offender Treatment Progress Scale (SOTIPS) score across the study duration measured at baseline, 30, 180 and 365 days post randomization., Whether add-back treatment with minimal or low dose testosterone is non-inferior for risk of committing sexual abuse in the primary variable
Endpoint(s): SOTIPS subscales sexual symptoms and antisocial opposition across the study duration, SOTIPS total scores at 30 days post randomization, SOTIPS total scores at 121 days post randomization, SOTIPS total scores at 244 days post randomization, SOTIPS total scores at 365 days post randomization, The SORB/SChiMRA scores across the study duration, measured at baseline and at weekly up till day 365. Self-rated, clinician-rated and proxy-rated scores will be analyzed separately., The HBI-19 total scores across the study duration, measured at baseline and at 7, 14, 60, 121, 182, 244, 304, 365 days post randomization., Total sexual outlet scores across the study duration, measured at baseline and at 14, 60, 121, 182, 244, 304, 365 days post randomization., Total score in the Sexual symptom assessment scale, and specific scores in the distress item across the study duration, measured at baseline, pre-treatment, 7 days, 14 days, each completed iCBT module, post-treatment, booster sessions and 365 days post randomization., Total score in the screening scale for sexual interests (LASSIE) measured at baseline, end of iCBT treatment and 365 days post randomization., Patient desire questionnaire (PDQ) total and subscale scores (Sexual desire, satisfaction and performance, sexual activity, mood) measured at baseline and at 14, 60, 121, 182, 244, 304, 365 days post randomization., Change in metabolic blood biomarkers across the study period measured at baseline and at 121, 244 and 365 days post randomization., Change in bone mineral density and body fat composition on DXA-scan measured at baseline and 365 days post randomization., Cumulative incidence of any AEs., Cumulative incidence of severe AEs, Cumulative incidence of suicidal ideation requiring any type of intervention, Time exposure to any mild, moderate and severe adverse events respectively during the trial duration., Time exposure to each adverse event reported by >5% of participants in any of four trial arms, Negative effects questionnaire (NEQ) scores reported at the end of iCBT-treatment., Quality of life measured with the EuroQol visual analogue scale (EQ-VAS) at baseline, each iCBT module, end of iCBT treatment and at 365 days post randomization, Quality and frequency of treatment experiences reported at 121, 244, 365 post randomization analysed with qualitative content analysis., SOTIPS-improvement from baseline to day 365 days post randomization, Reduction of distress-related to pedo-/pedohebephilic disorder measured with the SSAS item 10 and 11 over the study duration., SOTIPS-improvement from baseline to 121 days post randomization., Scores in an off-scanner sexual responsivity paradigm (such as the Viewing Time task or questionnaires such as the HBI-19), Compare treatment (degarelix versus placebo) induced neural changes, primarily in task-based bold activation but possibly also structural MRI and resting-state connectivity, Use multimodal neurobiological (e.g., cortical thickness, subcortical volumes, resting-state functional connectivity, task-based BOLD activation, pupil dilation, eye-tracking, pulse fluctuations, skin-conductance data incorporation) possibly withmultimodal machine-learning methods, to delineate neurobiologically different phenotypes at baseline., In an exploratory manner, test whether suggested disorder subtypes meaningfully predict (placebo or degarelix) treatment response over the study period., Time to treatment discontinuation from injections, Time to treatment discontinuation from iCBT, Number of extra visits, sessions or contacts in addition to those specified in the protocol, Time to rescue medication with CPA, Efficacy analyses in the primary endpoint with adjustment for CPA use., Time to rescue medication with tamoxifen, SOTIPS measured across the study duration, SSAS scores across the study duration (pedo-/pedohebephilic disorder), Baseline scores in the empathic concern subscale of the Brief interpersonal reactivity index (B-IRI), Baseline scores in the Ritvo Autism and Asperger diagnostic scale-revised (RAADS-14), ADHD-symptoms as reported in the MINI-neuropsychiatric interview.

Source: https://euclinicaltrials.eu/ctis-public/view/2024-518120-68-01